EU clinical trial 2023-503391-24-00: C5701002/SGN22E-002 - A study of enfortumab vedotin (ASG-22CE) as monotherapy or in combination with other anticancer therapies for the treatment of urothelial cancer
Protocol code: C5701002/SGN22E-002
Sponsor: Seagen Inc. (Pharmaceutical company). Phase: Therapeutic exploratory (Phase II). Countries: France (ended).
Therapeutic area(s): Diseases [C] - Neoplasms [C04]
Gender: Female, Male. Age: 18-64 years, 65+ years. Enrolment: 7.
Status: Ended. Start date (EU): 2021-05-26. End date (EU): 2026-02-09. End date: 2026-02-20. Decision date: 2023-09-28. Results received: No. Last updated: 2026-01-19.

Condition(s): Urothelial cancer
Product: Padcev 30 mg powder for concentrate for solution for infusion, KEYTRUDA 25 mg/mL concentrate for solution for infusion, Padcev 20 mg powder for concentrate for solution for infusion

Primary endpoint: Locally Advanced or Metastatic Urothelial Cancer ● Type, incidence, severity, seriousness, and relatedness of AEs ● Type, incidence, and severity of laboratory abnormalities, Randomized Cohort K ● ORR (confirmed) per RECIST Version 1.1 by BICR, Muscle Invasive Bladder Cancer ● pCR rate by central pathology review
Endpoint(s): ORR (confirmed) per RECIST Version 1.1 by investigator assessment, DOR per RECIST Version 1.1 by BICR, DOR per RECIST Version 1.1 by investigator assessment, DCR per RECIST Version 1.1 by BICR, DCR per RECIST Version 1.1 by investigator assessment, PFS per RECIST Version 1.1 by BICR, PFS per RECIST Version 1.1 by investigator, OS, Type, incidence, severity, seriousness, and relatedness of AEs, Type, incidence, and severity of laboratory abnormalities, Corresponding Additional/Exploratory Endpoints: Selected plasma or serum PK parameters of enfortumab vedotin, MMAE, and TAb, Corresponding Additional/Exploratory Endpoints: Incidence of ATA to enfortumab vedotin, Corresponding Additional/Exploratory Endpoints: Exploratory biomarkers of clinical activity, including relationship of Nectin-4 expression and PD-L1 expression status to response, Corresponding Additional/Exploratory Endpoints: PFS2 by investigator assessment, Corresponding Additional/Exploratory Endpoints: Change from baseline in PRO assessments of the EQ-5D-5L, EORTC QLQ-C30, and BPI-SF, For the EV+Pembro arm: ORR (confirmed) per iRECIST by investigator assessment, For the EV+Pembro arm: DOR per iRECIST by investigator assessment, For the EV+Pembro arm: DCR per iRECIST by investigator assessment, For the EV+Pembro arm: PFS per iRECIST by investigator assessment, ORR (confirmed) per RECIST Version 1.1 by BICR, EFS by BICR (Cohort L only), EFS by investigator assessment, pDS rate by central pathology review, DFS by BICR (Cohort L only), DFS by investigator assessment, Percentage of planned RC+PLND delayed due to treatment-related AEs

Source: https://euclinicaltrials.eu/ctis-public/view/2023-503391-24-00